EU clinical trial 2024-512616-21-00: TIRACAN; Open label phase 2 basket trial with Atezolizumab and Tiragolumab in solid tumors
Sponsor: Universitair Medisch Centrum Groningen (Hospital/Clinic/Other health care facility). Phase: Therapeutic exploratory (Phase II). Countries: Netherlands (ongoing, recruitment ended).
Therapeutic area(s): Diseases [C] - Neoplasms [C04]
Gender: Female, Male. Age: 18-64 years, 65+ years. Enrolment: 97.
Status: Ongoing, recruitment ended. Start date (EU): 2023-10-18. Decision date: 2024-11-04. Results received: No. Last updated: 2024-11-04.

Condition(s): HNSCC, metastatic deficient mismatch repair (dMMR)/MSI-high (MSI-H) tumors, irresectable or metastatic melanoma, locally advanced or metastatic solid tumor
Product: Tiragolumab, Tecentriq 1 200 mg concentrate for solution for infusion

Primary endpoint: Pathologic response of the primary tumor (pTR) in patients with HNSCC and ORR according to (i)RECIST 1.1 in patients with advanced or metastatic dMMR/MSI cancer, metastatic melanoma and patients with a locally advanced or metastatic solid tumor whom, in the opinion of the investigator, based on available clinical data, may benefit from treatment with anti-PD-L1 immunotherapy.
Endpoint(s): Safety assessment through: o Incidence, nature and severity of adverse events, including protocol-defined events of special interest such as described in section 10.1.6, graded according to NCI CTCAE 5.0 o Changes in laboratory test results, vital signs and physical findings., Assessment of DFS in patients with HNSCC. o DFS is defined as the time from surgery to the time of local, regional or distant disease recurrence or death, whichever comes first., Evaluation of ORR, PFS and DOR according to (i)RECIST, as assessed by the investigator for cohort 2, 3 and 4., The correlation between TIGIT, PD-1, PD-L1 and CD8 IHC expression on tumor tissue provided prior to start of treatment and inflammatory infiltrate with radiographic (CT or MRI) in cohort 2, 3, and pathologic response pTR in cohort 1 and 2.

Source: https://euclinicaltrials.eu/ctis-public/view/2024-512616-21-00